EU clinical trial 2023-503973-39-00: A Phase 3, Open-Label, Multicenter Study to Evaluate the Efficacy and Safety of Darvadstrocel in the Treatment of Complex Perianal Fistula in Pediatric Subjects with Crohn’s Disease over a Period of 24 Weeks and an Extended Follow-up Period for a Total of up to 52 Weeks
Protocol code: Darvadstrocel-3004
Sponsor: Takeda Development Center Americas Inc. (Pharmaceutical company). Phase: Therapeutic confirmatory (Phase III). Countries: Spain (ended), Netherlands (ended), Poland (ended).
Therapeutic area(s): Diseases [C] - Digestive System Diseases [C06]
Gender: Female, Male. Age: 0-17 years. Enrolment: 15.
Status: Ended. Start date (EU): 2021-03-16. End date (EU): 2025-05-07. End date: 2025-05-07. Decision date: 2023-07-07. Results received: Yes. Last updated: 2025-05-19.
Decision dates by country: PL: 2023-08-21, NL: 2023-07-07, ES: 2023-07-10

Condition(s): Complex Perianal Fistulas in Crohn's Disease
Product: Alofisel 5 million cells/mL suspension for injection

Primary endpoint: Proportion of subjects who achieve combined remission at Week 24, where combined remission is defined as: a) The closure of all treated external openings that were draining at baseline despite gentle finger compression AND b)Absence of abscess(es) >2 cm (in at least 2 dimensions) of the treated perianal fistula(s) confirmed by central (MRI) assessment.
Endpoint(s): Efficacy at Week 24: Proportion of subjects who achieve clinical remission at Week 24, where clinical remission is defined as the closure of all treated external openings that were draining at baseline despite gentle finger compression., Efficacy at week 24: Proportion of subjects with clinical response at Week 24, where clinical response is defined as closure of at least 50% of all treated external openings that were draining at baseline despite gentle finger compression., Efficacy at Week 52: Proportion of subjects who achieve clinical remission at Week 52, where clinical remission is defined as the closure of all treated external openings that were draining at baseline despite gentle finger compression., Efficacy at Week 52: Time to clinical remission (weeks) assessed at each clinic visit up to Week 52. This is defined as the time from treatment start to first visit at which clinical remission is observed before Week 52; where clinical remission is said to occur if a clinical assessment shows closure of all treated external openings that were draining at baseline despite gentle finger compression., Efficacy at Week 52: Proportion of subjects with clinical response at Week 52, where clinical response is defined as closure of at least 50% of all treated external openings that were draining at baseline despite gentle finger compression., Efficacy at Week 52: Time to clinical response (weeks) assessed at each clinic visit up to Week 52. This is defined as the time from treatment start to first visit at which clinical response is observed before Week 52; where clinical response is said to occur if a clinical assessment shows closure of at least 50% of all treated external openings that were draining at baseline despite gentle finger compression., Efficacy at Week 52: Proportion of subjects with relapse by Week 52, in subjects with combined remission at Week 24, where relapse is defined as reopening of any of the treated fistula(s) external openings with active drainage as clinically assessed in subjects who were in combined remission at Week 24., Safety Endpoints 1. Incidence of AEs. 2. Incidence of SAEs. 3. Incidence of adverse events of special interest (AESIs). 4. Vital signs. 5. Laboratory parameters (biochemistry, hematology, and urinalysis).

Source: https://euclinicaltrials.eu/ctis-public/view/2023-503973-39-00